EU clinical trial 2025-520978-18-00: A Participant- and Investigator--Blinded, Placebo-Controlled, Randomized, Multipart, Single and Multiple Ascending Dose Study to Investigate the Safety, Tolerability, Pharmacokinetics, and Pharmacodynamics of OJR520 in Healthy Volunteers and Participants with Chronic Kidney Disease
Protocol code: COJR520A12101
Sponsor: Novartis Pharma AG (Pharmaceutical company). Phase: Human Pharmacology (Phase I)- First administration to humans. Countries: Germany (authorised, recruitment pending), Romania (authorised, recruitment pending).
Therapeutic area(s): Diseases [C] - Female Urogenital Diseases and Pregnancy Complications [C13]; Diseases [C] - Male Urogenital Diseases [C12]
Gender: Female, Male. Age: 18-64 years, 65+ years. Enrolment: 44.
Status: Authorised, recruitment pending. Decision date: 2026-02-10. Results received: No. Last updated: 2026-07-20.
Decision dates by country: RO: 2026-02-12, DE: 2026-02-10

Condition(s): Chronic Kidney Disease

Source: https://euclinicaltrials.eu/ctis-public/view/2025-520978-18-00